EU clinical trial 2024-515598-82-00: A Multi-Center, Single-Arm Clinical Trial to Investigate the Efficacy and Safety of Elsunersen in Pediatric Participants with Early Onset SCN2A Developmental and Epileptic Encephalopathy
Protocol code: PRAX-222-311
Sponsor: Praxis Precision Medicines Inc. (Pharmaceutical company). Phase: Therapeutic confirmatory (Phase III). Countries: Italy (ongoing, recruiting), Germany (authorised, recruiting).
Therapeutic area(s): Diseases [C] - Congenital, Hereditary, and Neonatal Diseases and Abnormalities [C16]; Diseases [C] - Nervous System Diseases [C10]
Gender: Female, Male. Age: 0-17 years, 18-64 years. Enrolment: 25.
Start date (EU): 2026-04-14. Decision date: 2025-06-30. Results received: No. Last updated: 2026-05-27.
Decision dates by country: DE: 2025-07-04, IT: 2025-06-30

Condition(s): Voltage-gated sodium channel type II alpha subunit (SCN2A) developmental and epileptic encephalopathy (DEE)
Product: PRAX-222

Primary endpoint: Change in monthly (28 days) motor seizure frequency from baseline to treatment after 24 weeks
Endpoint(s): Responder rate - defined as a ≥50% reduction in monthly seizure frequency from baseline compared to treatment after 24 weeks (Treatment Period), Change in motor seizure-free days from baseline (Treatment and Extension Periods), Clinical Global Impression-Severity (CGI-S) at baseline compared to treatment after 24 weeks (Treatment and Extension Periods), Clinical Global Impression-Improvement (CGI-I) subdomains scores at each post-dose time point (Treatment and Extension Periods), Caregiver Global Impression-Severity (CgGI-S) at baseline compared to treatment after 24 weeks (Treatment and Extension Periods), Caregiver Global Impression-Improvement (CgGI-I) subdomains scores at each post-dose time point (Treatment and Extension Periods), Sleep assessment scores at baseline compared to each post-dose time point (Treatment and Extension Periods), Incidence and severity of treatment-emergent adverse events (TEAEs) (Treatment and Extension Periods), Changes in findings on physical and neurological examinations, vital sign measurements, clinical laboratory results and electrocardiogram (ECG) parameters (Treatment and Extension Periods), Plasma and cerebrospinal fluid (CSF) concentrations of elsunersen (Treatment Period), Plasma PK parameters of elsunersen (Treatment Period), Changes in the ASM regimen, dose and number of ASMs compared to Baseline (Extension Period Only), Peds QL Family Impact Module scores at baseline compared to each post-dose time point (Treatment and Extension Periods), Caregiver Exit Interview (Treatment and Extension Periods)

Source: https://euclinicaltrials.eu/ctis-public/view/2024-515598-82-00